EU clinical trial 2024-515847-47-00: Phase 2, Multicenter, Open label, Platform Study investigating Tarlatamab (AMG 757) in patients with Metastatic/Locally Advanced Small-Cell Lung Cancer (SCLC) and Other Poorly Differentiated Neuroendocrine Carcinomas (NECs), with biomarker analysis to characterize response/resistance (UNLOCK TARLATAMAB)
Protocol code: CSET 2024/4014
Sponsor: Institut Gustave Roussy (Hospital/Clinic/Other health care facility). Phase: Therapeutic exploratory (Phase II). Countries: France (ongoing, recruiting), Germany (ended).
Therapeutic area(s): Diseases [C] - Neoplasms [C04]
Gender: Female, Male. Age: 18-64 years, 65+ years. Enrolment: 40.
Start date (EU): 2025-06-24. Decision date: 2025-04-23. Results received: No. Last updated: 2026-02-12.
Decision dates by country: DE: 2025-09-26, FR: 2025-04-23

Condition(s): Metastaic small cell lung cancer (SCLC) and other poorly differentitated neuroendocrine carcinomas (NECs)
Product: Tarlatamab, Tarlatamab

Primary endpoint: Objective response rate (ORR) at 4 months.
Endpoint(s): Objective response rate (ORR) at different timepoints - Duration of response (DOR) - Clinical benefit rate (CBR) - Progression-free survival (PFS), Frequency and severity of any AEs, TEAEs, SAEsgraded by NCI-CTCAE v5.0; frequency and severity of CRS and ICANS graded according to American Society for Transplantation and Cellular Therapy (ASTCT) criteria (Lee et al, 2019); proportion of treatment discontinuations, interruptions, and dose reductions due to any AEs; frequency and severity of laboratory abnormalities defined by NCI-CTCAE v5.0;The use of immune modulating concomitant medication will be also summarized

Source: https://euclinicaltrials.eu/ctis-public/view/2024-515847-47-00